EU clinical trial 2023-505916-40-01: 68Ga-FAPI PET/CT: The Diagnostic Accuracy for Primary Staging and Re-staging after Chemotherapy in Patients with Gastric and Gastro-esophageal Junctional Cancer
Sponsor: Aalborg University Hospital (Hospital/Clinic/Other health care facility). Phase: Therapeutic exploratory (Phase II). Countries: Denmark (ended).
Therapeutic area(s): Diseases [C] - Neoplasms [C04]; Analytical, Diagnostic and Therapeutic Techniques and Equipment [E] - Diagnosis [E01]
Gender: Female, Male. Age: 18-64 years, 65+ years. Enrolment: 20.
Status: Ended. Start date (EU): 2024-02-15. End date (EU): 2025-12-18. Decision date: 2023-11-06. Results received: No. Last updated: 2025-03-10.

Condition(s): Gastroesophageal junction cancer (GEJ-cancer), Gastric cancer
Product: 68Ga-FAPI-46, Fluor-18-FDG, 400 MBq-210 GBq, injektionsvreske Fludeoxyglucose (18F)

Primary endpoint: Compare the FAPI PET/CT and FDG PET/CT findings in primary tumor, regional lymph nodes and distant metastases to a histopathological reference standard where the sensitivity, specificity, positive predicative value, and negative predicative values of the PET/CTs are determined, both at primary staging and at restaging, Compare the cancer stage (according to AJCC 8th edition TNM-classification) as determined by FAPI PET/CT compared to conventional imaging (including FDG PET/CT) at primary staging and at restaging (after neoadjuvant chemotherapy). The proportion of patients downstaged, unchanged stage, and upstaged, due to the added FAPI PET/CT are determined., Investigate the feasibility of FAPI PET/CT at restaging (after neoadjuvant chemotherapy) by comparing the FAPI PET/CT signal after neoadjuvant chemotherapy to a histopathological reference standard, Investigate the correlation between FAPI PET/CT SUV values and extent of FAP expressing CAFs in tumor deposits through volume-density estimation and immunohistochemical assessment of surgical specimens.
Endpoint(s): SUV and TBR values for primary, regional lymph nodes, and distant metastases for FAPI PET/CT and compare these values to FDG PET/CT, both at primary staging and at restaging (after neoadjuvant chemotherapy), Changes in SUV and TBR in primary, regional lymph nodes, and distant metastases for FAPI PET/CT - from before to after neoadjuvant chemotherapy and compare these values to the FDG PET/CT parameters., MTV and TLG for both FAPI PET/CT and FDG PET/CT at primary and restaging (after neoadjuvant chemotherapy) and compare these values between FAPI PET/CT and FDG PET/CT., Changes in MTV and TLG for both FAPI PET/CT and FDG PET/CT from before to after neoadjuvant chemotherapy and compare these values between FAPI PET/CT and FDG PET/CT., Seek supplementary information in medical records, biochemistry, pathology, or other imaging modalities for a final diagnosis/condition in cases of unexpected FAPI PET/CT findings not related to the known cancer, Correlate the FAPI PET/CT results/staging of patients to the actual clinical outcome and compare these to the FDG PET/CT results/staging. RFS and OS will be determined., Conduct an interobserver study of FAPI PET/CTs performed in the present and other future FAPI PET/CT in cancers studies., Investigate what proportion of patients will be (hypothetically) treated differently due to an added FAPI PET/CT at primary staging and at restaging (after neoadjuvant chemotherapy) by the treating clinicians, Note reported discomfort, and measure heart rate and blood pressure before and at specific timepoints after FAPI infusion.

Source: https://euclinicaltrials.eu/ctis-public/view/2023-505916-40-01